EU clinical trial 2023-508311-23-00: Explorative, randomized, double-blind, placebo-controlled, 3-way cross-over study to assess the effects of oral cannabidiol 30 and 700 mg in healthy male subjects on CNS and cortical excitability using the NeuroCart test battery and TMS.
Sponsor: Centre for Human Drug Research (Laboratory/Research/Testing facility). Phase: Therapeutic exploratory (Phase II). Countries: Netherlands (ended).
Therapeutic area(s): Not possible to specify
Gender: Male. Age: 18-64 years. Enrolment: 24.
Status: Ended. Start date (EU): 2023-11-20. End date (EU): 2024-03-14. Decision date: 2023-11-17. Results received: Yes. Last updated: 2024-01-18.

Condition(s): Neurological assessments
Product: Amygdalae Oleum Raffinatum, Clinican CBD 10% oil flavored

Primary endpoint: Saccadic eye movements, Smooth pursuit eye movements, Adaptive tracking, N-Back (working memory load), Visual Analog Scales (VAS) Bond and Lader; Bowdle, Visual Verbal Learning Test (VVLT) memory testing, Change from baseline in MEP, Change from baseline TMS evoked potential (TEP) measured using single pulse and paired pulse TMS at ISIs 2, 15 and 100 ms, Body Sway
Endpoint(s): PK parameters of cannabidiol by non-compartmental analysis of the plasma concentration-time data, Treatment-emergent (serious) adverse events ((S)AEs) throughout the study at every study visit, Concomitant medication throughout the study at every study visit, Vital signs (Pulse Rate (bpm), Systolic blood pressure (mmHg), Diastolic blood pressure (mmHg)) as per assessment schedule

Source: https://euclinicaltrials.eu/ctis-public/view/2023-508311-23-00